EU clinical trial 2023-509915-10-00: A Phase I Study of Belantamab Mafodotin in Multiple Myeloma Participants with Normal and Impaired Hepatic Function
Protocol code: 209627(DREAMM 13)
Sponsor: Glaxosmithkline Research & Development Limited (Pharmaceutical company). Phase: Human Pharmacology (Phase I)- Other. Countries: Greece (ended).
Therapeutic area(s): Diseases [C] - Neoplasms [C04]
Gender: Female, Male. Age: 18-64 years, 65+ years. Enrolment: 8.
Status: Ended. Start date (EU): 2021-07-27. End date (EU): 2025-10-28. End date: 2025-10-28. Decision date: 2024-04-12. Results received: No. Last updated: 2025-03-20.

Condition(s): Relapsed or Refractory Multiple Myeloma

Source: https://euclinicaltrials.eu/ctis-public/view/2023-509915-10-00